EU clinical trial 2023-509212-29-01: CARLA-M19 : “Prospective non-randomized phase I/II study investigating the safety of CD19 CAR-T cells in patients with refractory/relapsed AML expressing CD19.”
Protocol code: DRI_2021/0578
Sponsor: Centre Hospitalier Universitaire De Lille (Hospital/Clinic/Other health care facility). Phase: Phase I and Phase II (Integrated)- Other. Countries: France (authorised, recruiting).
Therapeutic area(s): Diseases [C] - Neoplasms [C04]
Gender: Female, Male. Age: 18-64 years, 65+ years. Enrolment: 5.
Status: Authorised, recruiting. Start date (EU): 2025-07-10. Decision date: 2024-10-07. Results received: No. Last updated: 2026-08-07.

Condition(s): Patients (male or female) ≥18 years old with R/R AML that expresses CD19 by Flow-cytometry
Product: MB-CART19.1, FLUDARABINE ACCORD 25 mg/ml, solution à diluer pour solution injectable/pour perfusion, CYCLOPHOSPHAMIDE SANDOZ 500 mg, poudre pour solution injectable ou pour perfusion

Primary endpoint: Number of patients deceased without progression at one month after CAR T-cell infusion. Non-progression mortality (NPM). NPM is defined as death occurred in patients without evidence of AML progression. Absence of response, progression or relapse of AML define progression status
Endpoint(s): Number of patients with manufacturing failure and out of specification (OOS) deviation, Duration of CAR-T cell persistence in blood after infusion evaluated by flow-cytometry and PCR, Number of patients with overall response at one-month, Response duration, and number of patients alive at 3, 6 and 12 months, Number of patients alive without relapse at 3, 6 and 12 months, Number of deaths without progression at 3, 6 and 12 months, Number of patients with complete remission (CR) at 1 and 3 months

Source: https://euclinicaltrials.eu/ctis-public/view/2023-509212-29-01